EU clinical trial 2024-516291-16-00: Study to Evaluate the PK and Safety of Oral Decitabine and Cedazuridine in Cancer Patients with Renal Impairment
Protocol code: ASTX727-17
Sponsor: Taiho Oncology Inc. (Pharmaceutical company). Phase: Human Pharmacology (Phase I)- Other. Countries: Slovakia (ongoing, recruiting), Bulgaria (ended), Romania (ongoing, recruiting), Spain (ongoing, recruiting), Poland (authorised, recruiting).
Therapeutic area(s): Diseases [C] - Neoplasms [C04]
Gender: Female, Male. Age: 18-64 years, 65+ years. Enrolment: 46.
Start date (EU): 2021-10-26. Decision date: 2024-09-09. Results received: No. Last updated: 2026-06-04.
Decision dates by country: ES: 2024-09-09, PL: 2024-10-07, SK: 2024-09-17, BG: 2024-09-13, RO: 2024-09-16

Condition(s): Acute myeloid lymphoma (AML), myelodysplastic syndrome (MDS), or solid tumors

Source: https://euclinicaltrials.eu/ctis-public/view/2024-516291-16-00